EU clinical trial 2024-516641-39-00: A Phase 1/2 Study to Assess the Safety, Pharmacokinetics, and Efficacy of Daily Intravenous of AB8939 in patients with Relapsed/Refractory Acute Myeloid Leukemia
Protocol code: AB18001
Sponsor: Ab Science (Pharmaceutical company). Phase: Phase I and Phase II (Integrated)- First administration to humans. Countries: Greece (temporarily halted), Spain (temporarily halted), France (temporarily halted), Germany (temporarily halted).
Therapeutic area(s): Diseases [C] - Hemic and Lymphatic Diseases [C15]
Gender: Female, Male. Age: 18-64 years, 65+ years. Enrolment: 60.
Status: Temporarily halted. Start date (EU): 2024-12-02. Decision date: 2024-12-02. Results received: No. Last updated: 2026-03-26.
Decision dates by country: DE: 2024-12-02, FR: 2024-12-04, GR: 2025-01-09, ES: 2024-12-02

Condition(s): Acute Myeloid Leukemia
Product: AB8939, Vidaza 25 mg/ml powder for suspension for injection, Venclyxto 100 mg film-coated tablets

Primary endpoint: Rate of dose-limiting toxicity (DLT)
Endpoint(s): Rate and duration of composite response rate (CRc) is defined as CRc = CR + CRh + CRi + CRp, Rate of ORR, PK parameters: Tmax, Cmax, AUC0-t, AUC0-inf, t1/2, Cl, Vd, after the first administration for all patients, Response rate based on the subtype of leukemia, risk-status, and genetic abnormalities

Source: https://euclinicaltrials.eu/ctis-public/view/2024-516641-39-00